EU clinical trial 2024-512142-42-00: A Phase III, Randomized, Double-Blind, Placebo-Controlled Study to Demonstrate the Efficacy and Safety of Tildrakizumab in Anti-TNF Naive Subjects with Active Psoriatic Arthritis II (INSPIRE 2)
Protocol code: TILD-19-19
Sponsor: Sun Pharmaceutical Industries Limited, Iqvia Biotech Limited, Labcorp Central Laboratory Services SARL (Pharmaceutical company). Phase: Therapeutic confirmatory (Phase III). Countries: Spain (ended), Germany (ended), Czechia (ended), Poland (ended).
Therapeutic area(s): Diseases [C] - Skin and Connective Tissue Diseases [C17]
Gender: Female, Male. Age: 18-64 years, 65+ years. Enrolment: 108.
Status: Ended. Start date (EU): 2021-10-05. End date (EU): 2025-04-10. Decision date: 2024-06-27. Results received: Yes. Last updated: 2025-03-17.
Decision dates by country: CZ: 2024-06-28, DE: 2024-06-27, ES: 2024-07-02, PL: 2024-07-24

Condition(s): Psoriatic Arthritis
Product: Ilumetri 100 mg solution for injection in pre-filled syringe, Tildrakizumab placebo solution for injection in pre-filled syringe

Primary endpoint: The proportion of subjects who achieve ACR20 at Week 24
Endpoint(s): The proportion of subjects achieving ACR50 at Week 24, The change from baseline in HAQ-DI at Week 24., The proportion of subjects achieving PASI75 response at Week24 among subjects with BSA ≥3% at baseline, The proportion of subjects achieving ACR70 at Week 24, The change from baseline in the van der Heijde modified total Sharp score at Week 24, The change from baseline in the van der Heijde modified total Sharp score at Week 16

Source: https://euclinicaltrials.eu/ctis-public/view/2024-512142-42-00